EU clinical trial 2024-518893-15-00: A Phase 3, Open-Label, Randomized Study of BGB-16673 Compared to Investigator’s Choice (Idelalisib Plus Rituximab or Bendamustine Plus Rituximab or Venetoclax Plus Rituximab Retreatment) in Patients With Chronic Lymphocytic Leukemia or Small Lymphocytic Lymphoma Previously Exposed to Both BTK and BCL2 Inhibitors
Protocol code: BGB-16673-302
Sponsor: BeOne Medicines AG (Pharmaceutical company). Phase: Therapeutic confirmatory (Phase III). Countries: Czechia (ongoing, recruiting), Italy (ongoing, recruiting), Poland (ongoing, recruiting), Germany (ongoing, recruiting), Netherlands (ongoing, recruiting).
Therapeutic area(s): Diseases [C] - Neoplasms [C04]
Gender: Female, Male. Age: 18-64 years, 65+ years. Enrolment: 57.
Status: Ongoing, recruiting. Start date (EU): 2025-07-29. Decision date: 2025-06-17. Results received: No. Last updated: 2026-06-08.
Decision dates by country: IT: 2025-06-20, DE: 2025-06-17, NL: 2025-11-17, CZ: 2025-06-17, PL: 2025-07-22

Condition(s): Chronic lymphotic leukemia and Small Lymphocytic lymphoma
Product: Zydelig 150 mg film-coated tablets, Zydelig 100 mg film-coated tablets, MabThera 500 mg concentrate for solution for infusion, Venclyxto 10 mg film-coated tablets, BGB-16673, MabThera 100 mg concentrate for solution for infusion, Levact 2,5 mg/ml poudre pour solution à diluer pour perfusion, BGB-16673, Venclyxto 100 mg film-coated tablets, Venclyxto 50 mg film-coated tablets

Primary endpoint: PFS, defined as time from the date of randomization to the date of first disease progression or death, whichever occurs first, as determined by IRC using modified 2018 International Workshop on Chronic Lymphocytic Leukemia (iwCLL) criteria for patients with chronic lymphocytic leukemia (CLL) and Lugano classification for patients with small lymphocytic lymphoma (SLL).
Endpoint(s): OS, defined as time from the date of randomization to the date of death due to any cause, PFS in patients who were exposed to ncBTKi, determined by IRC, PFS determined by investigator assessment, Overall response rate (partial response [PR] or better) determined by IRC and by investigator assessment, per modified 2018 iwCLL criteria for patients with CLL and Lugano classification for patients with SLL, Rate of PR with lymphocytosis or higher determined by IRC and by investigator assessment, Duration of response determined by IRC and by investigator assessment, Time to next anti-CLL/SLL treatment (TTNT), Incidence and severity of treatment-emergent adverse events (TEAEs), serious TEAEs, and laboratory abnormalities graded according to National Cancer Institute Common Terminology Criteria for Adverse Events (NCI-CTCAE) v5.0, Patient-reported symptom burden and physical condition/fatigue measured by European Organization for Research and Treatment of Cancer (EORTC) quality of life questionnairechronic lymphocytic leukemia module 17 items (QLQ-CLL17) and global health status (GHS) and physical functioning measured by EORTC quality of life questionnaire core 30 (QLQ-C30)

Source: https://euclinicaltrials.eu/ctis-public/view/2024-518893-15-00